EU clinical trial 2024-517165-17-00: Pharmacokinetics of antibiotics in bile fluid of patients with external biliary drainage
Sponsor: Medical University Of Vienna (Educational Institution). Phase: Human Pharmacology (Phase I)- Other. Countries: Austria (ongoing, recruiting).
Therapeutic area(s): Diseases [C] - Digestive System Diseases [C06]
Gender: Female, Male. Age: 18-64 years, 65+ years. Enrolment: 56.
Status: Ongoing, recruiting. Start date (EU): 2020-02-03. Decision date: 2024-09-08. Results received: No. Last updated: 2024-09-08.

Condition(s): Cholangitis

Source: https://euclinicaltrials.eu/ctis-public/view/2024-517165-17-00